EU clinical trial 2023-503442-30-00: A Phase 3 Randomized Study Comparing Teclistamab in Combination with Daratumumab SC and Lenalidomide (Tec-DR) and Talquetamab in Combination with Daratumumab SC and Lenalidomide (Tal-DR) versus Daratumumab SC, Lenalidomide, and Dexamethasone (DRd) in Participants with Newly Diagnosed Multiple Myeloma Who are Either Ineligible or not Intended for Autologous Stem Cell Transplant as Initial Therapy
Protocol code: 64007957MMY3005
Sponsor: Janssen - Cilag International (Pharmaceutical company). Phase: Therapeutic confirmatory (Phase III). Countries: Norway (ongoing, recruitment ended), Belgium (ongoing, recruitment ended), Poland (ongoing, recruitment ended), Czechia (ongoing, recruitment ended), Portugal (ongoing, recruitment ended), France (ongoing, recruitment ended), Austria (ongoing, recruitment ended), Italy (ongoing, recruitment ended), Spain (ongoing, recruitment ended), Netherlands (ongoing, recruitment ended), Germany (ongoing, recruitment ended), Denmark (ongoing, recruitment ended), Sweden (ongoing, recruitment ended), Greece (ongoing, recruitment ended).
Therapeutic area(s): Diseases [C] - Hemic and Lymphatic Diseases [C15]
Gender: Female, Male. Age: 18-64 years, 65+ years. Enrolment: 586.
Status: Ongoing, recruitment ended. Start date (EU): 2022-10-14. Decision date: 2024-08-26. Results received: No. Last updated: 2026-08-03.
Decision dates by country: AT: 2024-09-02, PL: 2024-08-29, ES: 2024-08-27, DK: 2024-08-26, PT: 2024-08-27, CZ: 2024-08-30, SE: 2024-08-29, FR: 2024-08-30, DE: 2024-08-28, GR: 2024-10-18, BE: 2024-08-26, IT: 2024-09-02, NO: 2024-08-26, NL: 2024-08-27

Condition(s): Multiple Myeloma
Product: Privigen 100 mg/ml solution for infusion, Lenalidomide Mylan 25 mg hard capsules, JNJ-64407564, Dexamethason 4 mg JENAPHARM®, Lenalidomide Accord 25 mg hard capsules, Lenalidomide Accord 15 mg hard capsules, Lenalidomide Accord 10 mg hard capsules, Dexamethasone Tablets BP 2.0mg, Fortecortin® 2 mg Tabletten, JNJ-64407564, Lenalidomide Accord 5 mg hard capsules, teclistamab, teclistamab, Dexamethason 8 mg GALEN® Tabletten, Lenalidomide Mylan 10 mg hard capsules, Lenalidomide Mylan 15 mg hard capsules, DARZALEX 1800 mg solution for injection, Privigen 100 mg/ml solution for infusion, Privigen 100 mg/ml solution for infusion, Lenalidomide Mylan 5 mg hard capsules

Primary endpoint: Dual primary endpoints: PFS; 12-month MRD-negative CR

Source: https://euclinicaltrials.eu/ctis-public/view/2023-503442-30-00